EU clinical trial 2023-503479-79-00: An Open-Label, Multicenter Extension Study of Trastuzumab Emtansine Administered as a Single Agent or in Combination with other Anti-Cancer Therapies in Patients Previously Enrolled in a Genentech and/or F. Hoffmann-La Roche Ltd–Sponsored Trastuzumab Emtansine Study
Protocol code: BO25430
Sponsor: F. Hoffmann-La Roche AG (Pharmaceutical company). Phase: Therapeutic exploratory (Phase II). Countries: Poland (ongoing, recruitment ended), Spain (ongoing, recruitment ended), Portugal (ended), France (ended), Belgium (ended).
Therapeutic area(s): Diseases [C] - Neoplasms [C04]
Gender: Female, Male. Age: 18-64 years, 65+ years. Enrolment: 60.
Start date (EU): 2011-06-17. Decision date: 2024-02-28. Results received: No. Last updated: 2026-07-08.
Decision dates by country: PT: 2024-02-28, BE: 2024-03-08, PL: 2024-04-02, ES: 2024-03-04, FR: 2024-03-01

Condition(s): Metastatic Cancer
Product: Kadcyla 160 mg powder for concentrate for solution for infusion., Tecentriq 1,200 mg concentrate for solution for infusion, Perjeta 420 mg concentrate for solution for infusion

Primary endpoint: 1. Incidence of adverse events leading to trastuzumab emtansine or combination treatment discontinuation or dose reduction., 2. Incidence of all adverse events and all serious adverse events

Source: https://euclinicaltrials.eu/ctis-public/view/2023-503479-79-00